EU clinical trial 2022-502322-41-00: A PHASE III, MULTICENTER, RANDOMIZED, OPEN-LABEL STUDY EVALUATING THE EFFICACY AND SAFETY OF INAVOLISIB PLUS FULVESTRANT VERSUS ALPELISIB PLUS FULVESTRANT IN PATIENTS WITH HORMONE RECEPTOR- POSITIVE, HER2-NEGATIVE, PIK3CA MUTATED, LOCALLY ADVANCED OR METASTATIC BREAST CANCER WHO PROGRESSED DURING OR AFTER CDK4/6 INHIBITOR AND ENDOCRINE COMBINATION THERAPY
Protocol code: WO43919
Sponsor: F. Hoffmann-La Roche AG (Pharmaceutical company). Phase: Therapeutic confirmatory (Phase III). Countries: Italy (ongoing, recruitment ended), Poland (ongoing, recruitment ended), Germany (ongoing, recruitment ended), France (ongoing, recruitment ended), Belgium (ongoing, recruitment ended), Spain (ongoing, recruitment ended).
Therapeutic area(s): Diseases [C] - Neoplasms [C04]
Gender: Female, Male. Age: 18-64 years, 65+ years. Enrolment: 150.
Status: Ongoing, recruitment ended. Start date (EU): 2023-09-12. Decision date: 2023-06-26. Results received: No. Last updated: 2026-02-10.
Decision dates by country: DE: 2023-06-27, BE: 2023-07-12, FR: 2023-06-27, ES: 2023-07-14, IT: 2023-06-27, PL: 2023-06-29

Condition(s): Metastatic breast cancer
Product: METFORMIN, Piqray 200 mg film-coated tablets, DEXAMETHASONE SODIUM PHOSPHATE, ALPELISIB, INAVOLISIB, INAVOLISIB, Piqray 150 mg film-coated tablets, FULVESTRANT, ALPELISIB, INAVOLISIB, Piqray 50 mg and 200 mg film-coated tablets, ALPELISIB

Primary endpoint: blinded independent central review (BICR-)-assessed progression-free survival (PFS)
Endpoint(s): Overall survival OS, BICR-assessed Overall Response Rate, BICR-assessed Best Overall Response, BICR-assessed Clinical benefit rate, BICR-assessed Duration of Response, . Time to confirmed a deterioration (TTCD) in pain, TTCD in physical functioning, TTCD in role functioning, TTCD in global health status/QOL, Incidence and severity of adverse events, with severity determined according to the National Cancer Institute Common Terminology Criteria for Adverse Events Version 5.0 (NCI CTCAE v5.0) grading scale; treatment discontinuations due to adverse events, Change from baseline in targeted clinical laboratory test results, Plasma concentration of inavolisib at specified timepoints

Source: https://euclinicaltrials.eu/ctis-public/view/2022-502322-41-00